EU clinical trial 2022-502634-52-00: A randomised, phase 3 trial comparing 3-weekly docetaxel 75 mg/m2 (in a 3 week cycle) versus 2-weekly Docetaxel 50 mg/m2 (in a 4 week cycle) in combination with Darolutamide + ADT in patients with metastatic hormone sensitive prostate cancer (mHSPC)
Protocol code: UTN-01-2022
Sponsor: Friedrich-Schiller-Universitaet Jena (Educational Institution). Phase: Therapeutic confirmatory (Phase III). Countries: Germany (ongoing, recruitment ended), Austria (ongoing, recruitment ended).
Therapeutic area(s): Diseases [C] - Male Urogenital Diseases [C12]
Gender: Male. Age: 18-64 years, 65+ years. Enrolment: 280.
Status: Ongoing, recruitment ended. Start date (EU): 2023-05-16. Decision date: 2023-05-12. Results received: No. Last updated: 2026-06-24.
Decision dates by country: AT: 2024-05-24, DE: 2023-05-12

Condition(s): prostate cancer
Product: Pamorelin® LA 22,5 mg Pulver und Lösungsmittel zur Herstellung einer Depot-Injektionssuspension, NUBEQA 300 mg film-coated tablets, Docetaxel AqVida 20 mg/ml Konzentrat zur Herstellung einer Infusionslösung, Zoladex® 3,6 mg Implantat, FIRMAGON 120 mg powder and solvent for solution for injection, Profact® Depot 6,3 mg 2-Monatsimplantat Wirkstoff: Buserelin, Orgovyx 120 mg film-coated tablets, ELIGARD 22,5 mg Pulver und Lösungsmittel zur Herstellung einer Injektionslösung

Primary endpoint: “Occurrence of a high grade (3 to 5) adverse event” (yes/no), which will be analyzed 26 weeks after last patient first docetaxel dose (LPFD), will be summarized as adverse event (AE) rate (AER). A secondary safety endpoint is “Occurence of neutropenia grade 3/4 AE or death regardless of reason”, which will be summarized as neutropenia AE rate (NAER)
Endpoint(s): PSA-response (PSA ≤0.2, >0.2-4.0 und >4.0 ng/ml) determined at week 26 after LPFD, Time to castration-resistant prostate cancer, Overall survival, Time to initiation of subsequent antineoplastic therapy, Time to first symptomatic skeletal event (SSE), Time to pain progression, Time to worsening of physical symptoms of disease based on functional assessment of cancer therapy / National Comprehensive Cancer Network prostate cancer symptom index 17 item questionnaire (NCCN-FACT FPSI-17), Treatment emergent adverse events according to NCI-CTCAE version 5.0, Long-term overall safety and tolerability, Quality of life, Prostate-specific antigen (PSA) assessments, Docetaxel-exposure-response analysis

Source: https://euclinicaltrials.eu/ctis-public/view/2022-502634-52-00